EU clinical trial 2024-510815-30-00: CART19 cells effects in patients with relapsed/refractory acute lymphoblastic leukemia and non-Hodgkin lymphoma.
Protocol code: UHKT-CAR19-01
Sponsor: Institute Of Hematology And Blood Transfusion (Hospital/Clinic/Other health care facility). Phase: Human Pharmacology (Phase I)- First administration to humans. Countries: Czechia (ongoing, recruiting).
Therapeutic area(s): Diseases [C] - Hemic and Lymphatic Diseases [C15]
Gender: Female, Male. Age: 18-64 years, 65+ years. Enrolment: 18.
Status: Ongoing, recruiting. Start date (EU): 2021-06-02. Decision date: 2024-07-23. Results received: No. Last updated: 2025-03-12.

Condition(s): Relapsed/refractory CD19+ Acute Lymphoblastic Leukaemia and Non-Hodgkin Lymphoma

Source: https://euclinicaltrials.eu/ctis-public/view/2024-510815-30-00